EU clinical trial 2024-514045-11-00: A Phase I, Open-Label, Pharmacokinetic, Dose-Escalation Study of Cenobamate (YKP3089) in Pediatric Subjects with Partial Onset Seizures
Protocol code: YKP3089C039
Sponsor: Sk Life Science Inc. (Pharmaceutical company). Phase: Human Pharmacology (Phase I)- Other. Countries: Spain (ended), Hungary (ended).
Therapeutic area(s): Diseases [C] - Nervous System Diseases [C10]
Gender: Female, Male. Age: 0-17 years. Enrolment: 4.
Status: Ended. Start date (EU): 2025-02-26. End date (EU): 2025-09-05. End date: 2025-11-06. Decision date: 2025-01-27. Results received: Yes. Last updated: 2025-04-24.
Decision dates by country: ES: 2025-01-27, HU: 2025-03-20

Condition(s): Partial Onset Seizures
Product: Cenobamate 10mg/mL

Primary endpoint: Pharmacokinetic assessment for cenobamate in plasma after a single dose 2. Pharmacokinetic assessment for cenobamate in plasma after multiple dosing
Endpoint(s): Safety and Tolerability • Treatment-emergent Adverse events, including AEs of special interest • Concomitant medication reporting • Safety laboratory tests • Electrocardiogram • Vital signs • Physical and neurological examination including growth measurements • Acceptability and palatability assessment, Efficacy • Seizure frequency data as the exploratory assessment of efficacy will be collected via seizure diary

Source: https://euclinicaltrials.eu/ctis-public/view/2024-514045-11-00